EU clinical trial 2024-513329-22-00: A Phase 1/2, Open-Label, Multicenter Study of KYV-101, an Autologous Fully-Human Anti-CD19 Chimeric Antigen Receptor T-Cell (CD19 CAR T) Therapy, in Subjects with Refractory Lupus Nephritis (KYSA-3)
Protocol code: KYV101-003
Sponsor: Kyverna Therapeutics Inc. (Pharmaceutical company). Phase: Phase I and Phase II (Integrated)- First administration to humans. Countries: Germany (ended).
Therapeutic area(s): Diseases [C] - Immune System Diseases [C20]
Gender: Female, Male. Age: 18-64 years, 65+ years. Enrolment: 32.
Status: Ended. Start date (EU): 2023-07-20. End date (EU): 2025-12-22. Decision date: 2024-06-27. Results received: No. Last updated: 2025-12-02.

Condition(s): Lupus Nephritis

Source: https://euclinicaltrials.eu/ctis-public/view/2024-513329-22-00